EU clinical trial 2024-515834-34-00: The value of post-operative antibiotic therapy after laparoscopic appendectomy for complicated acute appendicitis (other than for generalized peritonitis): a prospective, randomized, open-label, non-inferiority Phase III study.
Protocol code: PI2017_843_0002
Sponsor: Centre Hospitalier Universitaire Amiens Picardie (Hospital/Clinic/Other health care facility). Phase: Therapeutic confirmatory (Phase III). Countries: France (authorised, recruitment pending).
Therapeutic area(s): Diseases [C] - Digestive System Diseases [C06]
Gender: Female, Male. Age: 18-64 years, 65+ years. Enrolment: 1494.
Status: Authorised, recruitment pending. Decision date: 2024-11-20. Results received: No. Last updated: 2024-11-20.

Condition(s): complicated acute appendicitis
Product: METRONIDAZOLE, CEFTRIAXONE, SODIUM CHLORIDE, LEVOFLOXACIN

Primary endpoint: proportion of patients with deep SSIs by POD30. Deep SSIs are officially defined by the centre of disease control and prevention (CDC) (29) as infections that occur within 30 days of surgery AND appear to be related to the surgery AND affect the organ or the cavity around the surgical site (i.e. any anatomical structure – other than the incision – that is opened or handled during surgery) AND for which at least one sign defined in the protocol is observed
Endpoint(s): Quality of life prior to surgery and on discharge, using the SF36 questionnaires., The proportion of patients with superficial SSIs, The post-operative infection rates by POD30, including SSIs and remote infections, The number of antibiotic-free days between randomization and POD30., The description of the microbial flora, as found in the antibiogram of the per-operative sample that is collected in all cases, The balance between antibiotic therapy and microbial resistance. The antibiotic treatment will be considered to be adequate if no germs are found in the per-operative sample or if all of the detected germs are sensitive to the administered antibiotic therapy. The antibiotic treatment will be considered to be inadequate if the per-operative sample is positive for resistant germs, Morbidity and mortality according to the Dindo-Clavien classification (31) and the CCI, Slankamenac, Ann Surg, 2014; 260:757-62) (32), LOS, defined as the number of days of hospitalization between surgery and discharge, The rehospitalization rate, defined as rehospitalization during the study period

Source: https://euclinicaltrials.eu/ctis-public/view/2024-515834-34-00